EU clinical trial 2022-502327-22-00: A phase I, open-label, two-arm, non-randomised trial to investigate the metabolism and pharmacokinetics of a single dose of BI 764198 (C-14) administered as oral solution using two different approaches in healthy male volunteers.
Protocol code: 1434-0016
Sponsor: Boehringer Ingelheim International GmbH (Pharmaceutical company). Phase: Human Pharmacology (Phase I)- Other. Countries: Netherlands (ended).
Therapeutic area(s): Diseases [C] - Cardiovascular Diseases [C14]
Gender: Male. Age: 18-64 years, 65+ years. Enrolment: 16.
Status: Ended. Start date (EU): 2023-05-03. End date (EU): 2023-11-09. Decision date: 2023-04-12. Results received: Yes. Last updated: 2023-08-30.

Condition(s): Healthy

Primary endpoint: Mass balance recoveries of total radioactivity in urine and faeces: feurine,0-tz (fraction of [14C]-radioactivity excreted in urine expressed as percentage of the administered dose over the time interval from 0 to the last quantifiable time point)., Mass balance recoveries of total radioactivity in urine and faeces: fefaeces,0-tz (fraction of [14C]-radioactivity excreted in faeces expressed as percentage of the administered dose over the time interval from 0 to the last quantifiable time point).
Endpoint(s): The following endpoints will be determined for [14C]- radioactivity and for BI 764198: Cmax (maximum measured concentration of the analyte) in plasma., AUC0-tz (area under the concentration-time curve of the analyte over the time interval from 0 to the last quantifiable data point) in plasma.

Source: https://euclinicaltrials.eu/ctis-public/view/2022-502327-22-00